EU clinical trial 2023-505507-22-00: PENTALON - Pilot study for the evaluation of [68Ga]Ga-PentixaFor PET imaging for the identification of unilateral adrenal secretion of ALdosterON in patients with primary aldosteronism.
Protocol code: APHP220881
Sponsor: Assistance Publique Hopitaux De Paris (Hospital/Clinic/Other health care facility). Phase: Phase II and Phase III (Integrated). Countries: France (ended).
Therapeutic area(s): Diseases [C] - Cardiovascular Diseases [C14]
Gender: Female, Male. Age: 18-64 years, 65+ years. Enrolment: 60.
Status: Ended. Start date (EU): 2024-09-12. End date (EU): 2026-06-29. Decision date: 2024-03-18. Results received: No. Last updated: 2025-03-04.

Condition(s): Primary aldosteronism, Primary aldosteronism
Product: [68Ga]Ga-PentixaFor

Primary endpoint: Higher SUVmax between both adrenal glands on [68Ga]Ga-PTF-PET imaging, Ratio between SUVmax of both adrenal glands on [68Ga]Ga-PTF-PET imaging calculated as higher SUVmax / lower SUVmax of each adrenal gland, Difference between SUVmax of both adrenal glands on [68Ga]Ga-PTF-PET imaging calculated as the difference higher SUVmax - lower SUVmax of each adrenal gland, Ratio between the higher SUVmax among both adrenal glands and mean SUV of the liver on [68Ga]Ga-PTF-PET imaging
Endpoint(s): Aldosterone-to-cortisol ratio between the two adrenal veins on AVS (objective 1), Lateralization index during AVS (objective 1),, Ratio between the highest SUVmax among both adrenal glands and mean SUV of the liver on [68Ga]Ga-PTF-PET imaging (objective 2),, Secretion of aldosterone assessed with blood test after surgical adrenalectomy, dichotomized into persistence of PA at 6 months yes/no (objective 3),, CXCR4 expression levels by immuno-histochemistry (immunoreactive score or percentage of positive cells) (objective 4),, Adenoma sizes on CT and histology (objective 5), Safety and tolerance of [68Ga]Ga-PentixaFor injections (objective 6), Serious adverse events (any cause)., CYP11B2 expression levels by immuno- histochemistry (immunoreactive score or percentage of positive cells) (objective 7), Somatic mutation status of hypersecreting adrenal glands and APA (objective 8).

Source: https://euclinicaltrials.eu/ctis-public/view/2023-505507-22-00